EU clinical trial 2024-515997-28-00: DANOHCA: The Danish Out-of-Hospital Cardiac Arrest study
Protocol code: DANOHCA-001
Sponsor: Rigshospitalet (Hospital/Clinic/Other health care facility). Phase: Therapeutic confirmatory (Phase III). Countries: Denmark (ongoing, recruiting).
Therapeutic area(s): Diseases [C] - Cardiovascular Diseases [C14]
Gender: Female, Male. Age: 18-64 years, 65+ years. Enrolment: 1000.
Status: Ongoing, recruiting. Start date (EU): 2023-06-16. Decision date: 2024-10-11. Results received: No. Last updated: 2026-07-17.

Condition(s): Patients resuscitated from out-of-hospital cardiac arrest
Product: OLANZAPINE, PLACEBO, Dexavit, injektions-/infusionsvæske, opløsning, PLACEBO

Primary endpoint: Dexamethasone: All-cause mortality at 90 days in the two strata, modified intention to treat analysis. Log ranked test., Backrest: All-cause mortality at 90 days in the two strata, modified intention to treat analysis. Log ranked test., Early wakeup and extubation: Days alive outside hospital within 30 days* in the two strata, modified intention to treat analysis. For statistical analysis a Wilcoxon rank-sum test will be used., Olanzapine: Days alive outside hospital within 30 days* in the two strata, modified intention to treat analysis. For statistical analysis a Wilcoxon rank-sum test will be used.
Endpoint(s): Dexamethasone: Number of patients with one or more serious adverse reactions to dexamethasone in the ICU, Dexamethasone: Days alive outside hospital within 30 days, Dexamethasone: Cerebral Performance Category (CPC) and Modified Rankin Scale (mRS) at follow-up 3-6 months after cardiac arrest (conducted either through physical attendance or telephone interview according to participant preference), Dexamethasone: Serum Neuron Specific Enolase (NSE) at 48-72 hours, Dexamethasone: Markers of inflammation; high-sensitivity C reactive protein. platelet-, leukocyte- and differential count daily during the initial 72 hours, Backrest: Serum Neuron Specific Enolase (NSE) at 48 hours at sites where this is in routine use, Backrest: Duration of intubation (oral and tracheostomy combined), Backrest: ICU length of stay, Backrest: Days alive outside hospital within 30 days, Backrest: Hospital length of stay (including in-patient rehabilitation and transfer to referral hospital), Backrest: Cerebral Performance Category (CPC) and the modified Rankin Scale (mRS) at 3–6 months follow-up (conducted either through physical attendance or telephone interview according to participant preference, Early wakeup and extubation: All-cause mortality at 90 days, Early wakeup and extubation: Cerebral Performance Category (CPC) and the modified Rankin Scale (mRS) at 3–6 months. Note: • Cerebral Performance Category (CPC) and the modified Rankin Scale (mRS) at 3–6 months, Early wakeup and extubation: Duration of mechanical ventilation, Early wakeup and extubation: ICU length of stay, Early wakeup and extubation: Hospital length of stay, Olanzapine: All-cause mortality at 90 days:, Olanzapine: Number of CAM-ICU negative days at 30 days, Olanzapine: Number of days without pharmacological treatment for delirium (other than study drug during the intervention period), Olanzapine: Number of patients with one or more serious adverse reactions to olanzapine in the ICU, Olanzapine: Cerebral Performance Category (CPC) and Modified Rankin Scale (mRS) at follow-up 3-6 months after cardiac arrest

Source: https://euclinicaltrials.eu/ctis-public/view/2024-515997-28-00